EU clinical trial 2023-507379-23-00: A Long-term, Single-Arm, Open-label, Multicenter Trial to Evaluate Safety of Efgartigimod Administered Intravenously and Efgartigimod PH20 Administered Subcutaneously in Children With Generalized Myasthenia Gravis
Protocol code: ARGX-113-2008
Sponsor: Argenx (Pharmaceutical company). Phase: Phase II and Phase III (Integrated). Countries: Austria (ended), Germany (ongoing, recruiting), France (ongoing, recruiting), Italy (authorised, recruitment pending), Spain (ongoing, recruiting), Poland (ongoing, recruiting), Netherlands (ongoing, recruiting), Belgium (ongoing, recruiting), Czechia (authorised, recruitment pending).
Therapeutic area(s): Diseases [C] - Immune System Diseases [C20]
Gender: Female, Male. Age: 0-17 years. Enrolment: 19.
Start date (EU): 2022-08-18. Decision date: 2024-01-31. Results received: No. Last updated: 2026-07-13.
Decision dates by country: AT: 2024-02-27, BE: 2024-02-02, DE: 2024-02-01, ES: 2024-01-31, NL: 2024-02-05, CZ: 2025-06-12, PL: 2024-05-20, IT: 2024-02-05, FR: 2024-01-31

Condition(s): Generalized Myasthenia Gravis
Product: Vyvgart 1 000 mg solution for injection, Vyvgart 20 mg/mL concentrate for solution for infusion, ARGX-113

Primary endpoint: Incidence and severity of adverse events (AEs), Incidence and severity of serious adverse events (SAEs), Incidence and severity of adverse events of special interest (AESIs), Changes in laboratory test results, vital signs, height and weight, and electrocardiogram (ECG) results
Endpoint(s): Incidence and prevalence of antidrug antibodies (ADAs) against efgartigimod and antibodies against recombinant human hyaluronidase PH20 (rHuPH20).

Source: https://euclinicaltrials.eu/ctis-public/view/2023-507379-23-00